EU clinical trial 2024-515026-86-00: A Phase 2b, Randomized, Double-Blind, Placebo-Controlled Study to Assess the Efficacy, Safety, and Tolerability of Taplucainium Inhalation Powder (NOC-110) in Adults with Refractory or Unexplained Chronic Cough
Protocol code: NOC110-C-202
Sponsor: Nocion Therapeutics Inc. (Pharmaceutical company). Phase: Therapeutic exploratory (Phase II). Countries: Belgium (ended), Poland (ended), Germany (ended).
Therapeutic area(s): Diseases [C] - Respiratory Tract Diseases [C08]
Gender: Female, Male. Age: 18-64 years, 65+ years. Enrolment: 66.
Status: Ended. Start date (EU): 2024-12-18. End date (EU): 2026-06-29. End date: 2026-06-29. Decision date: 2024-11-29. Results received: No. Last updated: 2026-05-07.
Decision dates by country: PL: 2024-12-02, BE: 2024-11-29, DE: 2024-12-19

Condition(s): Refractory or Unexplained Chronic Cough
Product: Taplucainium Inhalation Powder, Taplucainium Inhalation Powder, Taplucainium Inhalation Powder, Placebo is a blend of inhalation grade lactose with arginine, it is taste masked to the active ingredient to minimize unblinding.

Primary endpoint: Change in 24-hour Coughs per hour from Baseline to Day 28 (based on VitaloJAK® Cough Counts)
Endpoint(s): Change in Awake coughs per hour from Baseline to Day 28 (based on VitaloJAK® Cough Counts), Change in the Cough Severity Visual Analog Scale (CS-VAS) from Baseline to Day 28, Change in the Urge to Cough Visual Analog Scale (UC-VAS) from Baseline to Day 28, Change in the Leicester Cough Questionnaire (LCQ) from Baseline to Day 28, Patient Global Impressions of Improvement (PGI-I) score at Day 28, Incidence and severity of adverse events (AEs) and serious adverse events (SAEs)

Source: https://euclinicaltrials.eu/ctis-public/view/2024-515026-86-00